EU clinical trial 2022-502832-37-00: HOVON 150 AML: A phase 3, multicenter, double-blind, randomized, placebo-controlled study of ivosidenib or enasidenib in combination with induction therapy and consolidation therapy followed by maintenance therapy in patients with newly diagnosed acute myeloid leukemia or myelodysplastic syndrome with excess blasts-2, with an IDH1 or IDH2 mutation, respectively, eligible for intensive chemotherapy.
Protocol code: HO150
Sponsor: Hemato-Oncologie voor Volwassenen Nederland (Hovon) Stichting (Hospital/Clinic/Other health care facility). Phase: Therapeutic confirmatory (Phase III). Countries: Netherlands (ongoing, recruitment ended), Finland (ongoing, recruitment ended), Estonia (ongoing, recruitment ended), Spain (ongoing, recruitment ended), Sweden (ongoing, recruitment ended), France (ongoing, recruitment ended), Ireland (ongoing, recruitment ended), Belgium (ongoing, recruitment ended), Austria (ongoing, recruitment ended), Norway (ongoing, recruitment ended), Germany (ongoing, recruitment ended), Lithuania (ongoing, recruitment ended).
Therapeutic area(s): Diseases [C] - Neoplasms [C04]
Gender: Female, Male. Age: 18-64 years, 65+ years. Enrolment: 852.
Status: Ongoing, recruitment ended. Start date (EU): 2019-03-01. Decision date: 2024-11-12. Results received: No. Last updated: 2026-06-26.
Decision dates by country: AT: 2024-11-19, EE: 2024-11-19, FI: 2024-11-13, IE: 2024-11-12, LT: 2024-11-28, ES: 2024-11-12, SE: 2024-11-13, NO: 2024-11-21, BE: 2024-11-14, FR: 2024-11-13, DE: 2024-11-14, NL: 2024-11-12

Condition(s): Acute myeloid leukemia, Myelodysplastic syndrome
Product: AG-120/S95031 250mg film-coated tablet, Ivosidenib-matched placebo tablets, Enasidenib Mesilate, Lactose monohydrate, microcrystalline cellulose, CrosCarmellose Sodium, Magnesium stearate, Opadry II Yellow

Primary endpoint: Event-free survival (EFS), defined as the time from randomization to failure to achieve CR or CRi after remission induction, death after achieving CR or CRi or relapse after achieving CR or CRi, whichever occurs first. A patient is said to have failed to achieve CR or CRi after induction therapy, if his/her best response during or at completion of the induction treatment is less than CRi., Primary end point 1 continued: Patients who achieved CR/CRi after remission induction and are not known to have relapsed or died will be censored at the date of last clinical assessment.
Endpoint(s): Overall survival (OS), defined as the time from date of randomization to date of death due to any cause. Patients still alive or lost to follow up will be censored at the time they were last known to be alive., Relapse-free survival (RFS), defined as time from the date of achievement of CR/CRi until relapse or death from any cause, whichever comes first. Patients still in first CR/CRi and alive or lost to follow up will be censored at the date of last clinical assessment., Cumulative incidence of relapse (CIR) after CR/CRi, as measured from the date of achievement of CR/CRi until the date of relapse. Patients not known to have relapsed will be censored on the date of last clinical assessment. Patients who died without relapse will be counted as a competing cause of failure., Cumulative incidence of death (CID) after CR/CRi, as measured from the date of achievement of CR/CRi until the date of death from any cause. Patients not known to have died will be censored on the date they were last known to be alive. Patients who experienced relapse in CR/CRi will be counted as competing cause of failure., CR without minimal residual disease (CRMRD−) rate after induction cycle 2, defined as CR/CRi with negativity for a genetic marker by realtime quantitative polymerase chain reaction (RT-qPCR), and with negativity by multi-color flow cytometry, if studied pre-treatment., Frequency and severity of adverse events according to CTCAE version 5.0., CR and CR with incomplete hematologic recovery (CRi) rates after induction cycle 1 and after induction cycle 2, as determined by the Investigator, based on the European LeukemiaNet (ELN2017) recommended response criteria18., CR+CRi rate after remission induction (i.e., CR or CRi as best response during or at completion of induction therapy)., Time to hematopoietic recovery after each chemotherapy treatment cycle, defined as the time from the start of the cycle until recovery., Quality of life as assessed by EQ-5D-5L visual analogue scale (VAS) and EQ-5D domains., Quality of life as assessed by EORTC-QLQ-C30 global health status/QoL scale and other QLQ-C30 subdomains.

Source: https://euclinicaltrials.eu/ctis-public/view/2022-502832-37-00